EU clinical trial 2022-500783-35-00: International multicenter, open-label clinical trial for the treatment of acute myeloid leukemia in children and adolescents
Protocol code: AIEOP-BFM AML 2020
Sponsor: GPOH gGmbH (Patient organisation/association). Phase: Therapeutic confirmatory (Phase III). Countries: Germany (temporarily halted), Austria (temporarily halted), Poland (temporarily halted), Italy (temporarily halted), Czechia (temporarily halted), Greece (temporarily halted).
Therapeutic area(s): Diseases [C] - Neoplasms [C04]
Gender: Female, Male. Age: 0-17 years, 18-64 years. Enrolment: 1091.
Status: Temporarily halted. Start date (EU): 2022-12-06. Decision date: 2022-09-27. Results received: No. Last updated: 2025-09-25.
Decision dates by country: AT: 2023-10-02, CZ: 2023-09-27, GR: 2023-09-27, IT: 2023-10-02, DE: 2022-09-27, PL: 2023-09-27

Condition(s): Acute Myeloid Leukemia
Product: IDARUBICIN HYDROCHLORIDE, CYTARABINE, CYCLOPHOSPHAMIDE, Vyxeos Liposomal 44 mg/100 mg powder for concentrate for solution for infusion., METHOTREXATE, MITOXANTRONE HYDROCHLORIDE, ETOPOSIDE, CYTARABINE, MELPHALAN, BUSULFAN, FLUDARABINE, GEMTUZUMAB OZOGAMICIN, PREDNISOLONE, THIOTEPA, TREOSULFAN

Primary endpoint: Group A1-A3: The primary endpoint is Event Free Survival (EFS), Group B: The primary endpoint is Overall Survival (OS). OS is defined as the time from inclusion to death from any cause. Survivors will be censored at the date of the last follow-up evaluation, Group C: A composite endpoint will be used as primary endpoint. Graft-versus host disease, VOD, Relapse Free Survival (GVRDS) is defined as the time from randomization to first failure event.
Endpoint(s): Group A, C: Overall survival (OS), Group B, C: Event Free Survival (EFS), All Groups: Cumulative incidence of Relapse (CIR), All Groups: Non-relapse mortality (NRM), Group A: Primary induction failures, Group A: Risk-Group after Induction 2 Disease-free survival (DFS), Group A: Blast at Ind1, Group A: MRD-level at Ind1, Group A: MRD-level at Ind2, Group A-C: Adverse Events, Group A-C: Early death Complete remission (CR), Group A-C: CNS infestation (CICNS), Group C: Graft failure, Group C: Engraftment, Group C: aGvHD, Group C: cGvHD, Group C: VOD Grade 3/4

Source: https://euclinicaltrials.eu/ctis-public/view/2022-500783-35-00